EU clinical trial 2024-515104-39-00: A CLINICAL STUDY TO ASSESS THE EFFICACY AND SAFETY OF LERIGLITAZONE IN ADULT MALE SUBJECTS WITH CEREBRAL ADRENOLEUKODYSTROPHY
Protocol code: MT-3-01
Sponsor: Minoryx Therapeutics S.L. (Pharmaceutical company). Phase: Therapeutic confirmatory (Phase III). Countries: Spain (ongoing, recruitment ended), Germany (ongoing, recruitment ended), France (ongoing, recruitment ended).
Therapeutic area(s): Diseases [C] - Nervous System Diseases [C10]
Gender: Male. Age: 18-64 years, 65+ years. Enrolment: 15.
Status: Ongoing, recruitment ended. Start date (EU): 2024-12-02. Decision date: 2024-10-24. Results received: No. Last updated: 2026-07-10.
Decision dates by country: ES: 2024-10-24, FR: 2024-10-28, DE: 2024-10-29

Condition(s): Cerebral adrenoleukodystrophy (cALD)
Product: The MIN-102 Placebo is supplied as an oral suspension with similar appearance to MIN-102 drug product. MIN-102 placebo oral suspension is packaged in an amber glass bottle with filled volume based on the required clinical dose.

Primary endpoint: The primary endpoint will be the time to death or the subject becoming bedridden with a requirement for permanent ventilatory support, whichever comes earlier, in subjects treated with leriglitazone compared to placebo.
Endpoint(s): Change from Baseline in Loes score., To evaluate the efficacy of leriglitazone compared to placebo on the following clinical parameters: - Time to increase of at least 1 MFD in the NFS-MFD scale - Change from Baseline in ADL – section II of the Friedreich’s Ataxia Rating Scale (FARS) - Time to Major Neurocognitive Impairment – defined as dementia with loss of all intellectual functions requiring constant supervision or assistance, Performed at final analysis (with the analysis following the primary endpoint being met): • Change from Baseline of NFS • Change from Baseline of Symbol Digit Modalities Test (SDMT) cognitive assessment • Clinician Global Impression - Severity and Clinician Global Impression - Change of symptoms (CGI-S, CGI-C, and anchored scale for CGI-C) • Change from Baseline in plasma neurofilament light chain protein (NfL) • Change from Baseline in European Quality of Life 5 Dimensions (EQ-5D-5L), To evaluate the effects of leriglitazone on complementary biomarkers, and clinical and imaging parameters, To assess PK parameters of leriglitazone (plasma) – predicted area under the time-concentration curve (AUC), minimum plasma concentration (Cmin) at all visits, and maximum plasma concentration (Cmax) (only at the 6-month visit)., Cerebrospinal fluid leriglitazone and M3 concentrations change from Baseline (only at 12-month visit and if optional CSF samples have been collected).

Source: https://euclinicaltrials.eu/ctis-public/view/2024-515104-39-00